EU clinical trial 2023-504519-34-01: Using live vaccines to induce beneficial innate immune training and reduce systemic inflammation in COPD patients (COPD-LIVE)
Sponsor: Gentofte Hospital (Hospital/Clinic/Other health care facility). Phase: Therapeutic exploratory (Phase II). Countries: Denmark (ended).
Therapeutic area(s): Diseases [C] - Respiratory Tract Diseases [C08]; Phenomena and Processes [G] - Cell Physiological Phenomena [G04]; Phenomena and Processes [G] - Immune System Phenomena [G13]
Gender: Female, Male. Age: 18-64 years, 65+ years. Enrolment: 60.
Status: Ended. Start date (EU): 2024-02-22. End date (EU): 2025-08-25. Decision date: 2023-12-11. Results received: No. Last updated: 2024-04-23.

Condition(s): Chronic obstructive pulmonary disease
Product: M-M-RvaxPro powder and solvent for suspension for injection Measles, mumps and rubella vaccine (live), SALINE, BCG Vaccine "AJ Vaccines", pulver og solvens til injektionsvæske, suspension

Primary endpoint: Innate immune training, detected as fold-changes in cytokine production capacity of innate immune cells for cytokines such as IL-1β, IL-6, IL-10, TNF-α and IFN-γ, following pro-inflammatory stimulation from inclusion to 4 months post- inclusion.
Endpoint(s): Innate immune training, detected as fold-changes in cytokine production capacity of innate immune cells for cytokines such as IL-1β, IL-6, IL-10, TNF-α and IFN-γ, following pro-inflammatory stimulation from 3 to 4 months post- inclusion., Innate immune training, detected as fold-changes in cytokine production capacity of innate immune cells for cytokines such as IL-1β, IL-6, IL-10, TNF-α and IFN-γ, following pro-inflammatory stimulation from 1 to 3 months post- inclusion., Changes in blood levels of pro-inflammatory cytokines from inclusion to 3- and 4-months post- inclusion, Changes in epigenetic markers of innate immune cells., Number of hospital admissions, number of COPD exacerbations, and mortality 12 months after inclusion, Change in MRC, CAT and self-reported health from baseline to 12 months post-enrolment.

Source: https://euclinicaltrials.eu/ctis-public/view/2023-504519-34-01